EU clinical trial 2024-516051-40-00: A Phase 2, Open-label, Randomized, Multicenter Study of Tarlatamab Dosing Regimens in Subjects with Small Cell Lung Cancer (SCLC) (DeLLphi-309)
Protocol code: 20240092
Sponsor: Amgen Inc. (Pharmaceutical company). Phase: Therapeutic exploratory (Phase II). Countries: Germany (ongoing, recruitment ended), France (ongoing, recruitment ended), Greece (ongoing, recruitment ended), Italy (ongoing, recruitment ended), Spain (ongoing, recruitment ended), Belgium (ongoing, recruitment ended).
Therapeutic area(s): Diseases [C] - Neoplasms [C04]
Gender: Female, Male. Age: 18-64 years, 65+ years. Enrolment: 92.
Status: Ongoing, recruitment ended. Start date (EU): 2025-06-10. Decision date: 2025-05-05. Results received: No. Last updated: 2026-07-30.
Decision dates by country: FR: 2025-05-12, BE: 2025-05-09, DE: 2025-05-08, IT: 2025-05-05, ES: 2025-06-10, GR: 2025-05-05

Condition(s): Small Cell Lung Cancer (SCLC)
Product: SILTUXIMAB, Tarlatamab, Tarlatamab

Primary endpoint: Confirmed OR (CR + PR), CR (Complete Response), PR (Partial Response)
Endpoint(s): serum concentrations of tarlatamab, DOR - Duration of confirmed response, DC -Disease control is defined as objective response or stable disease., Duration of DC, PFS-Progression-free survival, OR - Objective response is defined as best overall response of CR or PR., Overall survival (OS) -Overall survival is defined as the time from randomization to death due to any cause., OS rate at 6 months and 1 year from randomization, Incidence of treatment-emergent adverse events, Incidence of anti-tarlatamab antibody formation

Source: https://euclinicaltrials.eu/ctis-public/view/2024-516051-40-00